EU clinical trial 2024-518844-20-00: A Multi-Center Phase 2/3 Randomized, Double-Blind, Placebo-Controlled, Parallel Group Safety and Efficacy Study of Dapansutrile Tablets in Subjects with an Acute Gout Flare
Protocol code: OLT1177-08
Sponsor: Olatec Therapeutics LLC (Pharmaceutical company). Phase: Phase II and Phase III (Integrated). Countries: Netherlands (ongoing, recruiting), France (ongoing, recruiting), Spain (ongoing, recruiting).
Therapeutic area(s): Diseases [C] - Musculoskeletal Diseases [C05]
Gender: Female, Male. Age: 18-64 years, 65+ years. Enrolment: 98.
Status: Ongoing, recruiting. Start date (EU): 2023-10-03. Decision date: 2024-11-04. Results received: No. Last updated: 2026-08-06.
Decision dates by country: ES: 2024-11-04, FR: 2024-11-04, NL: 2024-11-05

Condition(s): Treatment of Acute Gout Flare
Product: Paracetamol HTP 500 mg, tabletten, Dapansutrile, Placebo to match

Primary endpoint: The primary clinical activity outcome measurement will be: • Change from baseline in the subject-assessed pain intensity score (100-mm VAS) in the target joint at 72 hours post initial loading dose for dapansutrile compared to placebo.
Endpoint(s): The secondary clinical activity outcome measurements will be: • Change from baseline in the subject-assessed pain intensity score (100-mm VAS) in the target joint at 12, 24, 36, 48, and 60 hours post initial loading dose, and on Study Day 8 and Study Day 15, Subject-assessed PGART on Study Day 8, Change from baseline in the Investigator-assessed Target Joint Score (tenderness, swelling, erythema, warmth, and range of motion) at scheduled assessments through Study Day 15, Investigator-assessed IGART at scheduled assessments through Study Day 8, Proportion of subjects with a response (defined as a 20%, 50%, or 70% reduction from baseline without using Rescue Medication or Escape Medication) in the subject-assessed pain intensity score (100-mm VAS) in the target joint at 48 and 72 hours post initial loading dose, and on Study Day 8 and Study Day 15, Time to intake of medication taken for non-response, e.g., Rescue Medication and/or Escape Medication, from first IMP administration, Proportion and number of subjects with Rescue Medication or Escape Medication use from the first IMP administration up to 12 hours, >12 to 24 hours, >24 to 48 hours, >48 to 72 hours, >72 hours to Day 8, and >Day 8 to Day 15, Change from baseline in the subject-assessed QoL questionnaire (SF-12v2) at scheduled assessments through Study Day 15, Change from baseline in the subject-assessed pain intensity score (100-mm VAS) in any actively flaring non-target joint(s) on Study Day 4, Study Day 8, and Study Day 15.

Source: https://euclinicaltrials.eu/ctis-public/view/2024-518844-20-00